EU clinical trial 2023-508386-32-00: A First in Human open label study to evaluate the Safety, Tolerability, Pharmacokinetics, Pharmacodynamics and Preliminary Anti-Tumor Activity of VVD-130850 as Single Agent and in Combination with Checkpoint Inhibition in Participants with Advanced Solid and Hematologic Tumors.
Protocol code: VVD-130850-01
Sponsor: Vividion Therapeutics Inc. (Pharmaceutical company). Phase: Human Pharmacology (Phase I)- First administration to humans. Countries: Spain (ended).
Therapeutic area(s): Diseases [C] - Neoplasms [C04]
Gender: Female, Male. Age: 18-64 years, 65+ years. Enrolment: 40.
Status: Ended. Start date (EU): 2024-05-10. End date (EU): 2025-10-27. Decision date: 2024-03-25. Results received: No. Last updated: 2025-10-20.

Condition(s): Hematologic tumors, Advanced solid tumors

Source: https://euclinicaltrials.eu/ctis-public/view/2023-508386-32-00